EU clinical trial 2024-518376-31-00: Clinical Trial To Determine The Effectiveness And Safety Of Topical Insulin In Dry Eye
Protocol code: 1INSULINAOJOSECO2021
Sponsor: Hospital Clinico San Carlos (Hospital/Clinic/Other health care facility). Phase: Therapeutic use (Phase IV). Countries: Spain (ended).
Therapeutic area(s): Diseases [C] - Eye Diseases [C11]
Gender: Female, Male. Age: 18-64 years, 65+ years. Enrolment: 120.
Status: Ended. Start date (EU): 2022-10-19. End date (EU): 2025-11-05. Decision date: 2024-10-18. Results received: Yes. Last updated: 2024-10-18.

Condition(s): Dry eye disease
Product: ARTIFICIAL TEARS AND OTHER INDIFFERENT PREPARATIONS, CICLOSPORIN, INSULIN (HUMAN)

Primary endpoint: Change of corneal staining from baseline to 6 months after treatment
Endpoint(s): Changes in dry eye symptoms from baseline to 6 months after treatment time, Changes in esthesiometry from baseline to 6 months after treatment time, Changes in tear rupture time from baseline to 6 months after treatment time, Chnges in conjunctival hyperemia from baseline to 6 months of treatment, Proportion of patients presenting adverse effects

Source: https://euclinicaltrials.eu/ctis-public/view/2024-518376-31-00